EU clinical trial 2025-521047-20-00: Opioid-Free General Anesthesia Compared to Opioid-Based General Anesthesia for the Reduction of Postoperative Nausea and Vomiting in Patients Undergoing Robotic Bariatric Surgery - ANGELO Study
Protocol code: ANGELO
Sponsor: Institut De Recerca Biomedica De Lleida Fundacio Dr. Pifarre (Laboratory/Research/Testing facility). Phase: Therapeutic use (Phase IV). Countries: Spain (temporarily halted).
Therapeutic area(s): Analytical, Diagnostic and Therapeutic Techniques and Equipment [E] - Anesthesia and Analgesia [E03]
Gender: Female, Male. Age: 18-64 years, 65+ years. Enrolment: 64.
Status: Temporarily halted. Start date (EU): 2025-11-13. Decision date: 2025-07-22. Results received: No. Last updated: 2025-07-22.

Condition(s): Obesity
Product: Sulfato de Magnesio Altan 150 mg/ml solución inyectable y para perfusión EFG, LIDOCAINE HYDROCHLORIDE, Dexdor 100 micrograms/ml concentrate for solution for infusion, KETOLAR 50 mg/ml solución inyectable.

Primary endpoint: Visual Analog Scale for Nausea (VAS-N)
Endpoint(s): Visual Analog Scale for Pain (VAS-P), Opioid demand during the 24 hours following surgery

Source: https://euclinicaltrials.eu/ctis-public/view/2025-521047-20-00